EU clinical trial 2023-508497-28-00: A Phase 2, randomised, open label, multicentre study of an intraperitoneal α-emitting radionuclide therapy (Radspherin®) in patients with primary advanced high-grade serous or high-grade endometrioid epithelial ovarian, fallopian tube, or primary peritoneal cancer, with peritoneal metastasis that are homologous recombination proficient and scheduled to undergo neoadjuvant chemotherapy and interval debulking surgery
Sponsor: Oncoinvent Solutions AS (Pharmaceutical company). Phase: Therapeutic exploratory (Phase II). Countries: Belgium (ongoing, recruiting), Norway (ongoing, recruiting), Spain (ongoing, recruiting), Italy (ongoing, recruiting).
Therapeutic area(s): Diseases [C] - Neoplasms [C04]
Gender: Female. Age: 18-64 years, 65+ years. Enrolment: 75.
Status: Ongoing, recruiting. Start date (EU): 2024-06-05. Decision date: 2024-04-18. Results received: No. Last updated: 2026-07-08.
Decision dates by country: NO: 2024-04-24, BE: 2024-04-18, ES: 2024-04-18, IT: 2025-07-25

Condition(s): Carcinomatosis of peritoneal cavity
Product: Radspherin

Primary endpoint: PFS defined as time from randomisation until the date of first progression or death, whichever occurs first. PFS will be assessed using computed tomography (CT) or magnetic resonance imaging (MRI) and according to Response Evaluation Criteria in Solid Tumours (RECIST) v1.1.
Endpoint(s): OS defined as time from date of randomisation until the date of death from any cause., PPFS defined as the date from randomisation until the date of first progression in the peritoneum or death for any cause, whichever occurs first. PPFS will be assessed using CT/MRI and according to RECIST v1.1., TFST defined as the time from the date of randomisation until the date of first subsequent anticancer therapy or death from any cause, whichever occurs first. Planned post-operative chemotherapy and planned maintenance therapy is considered as a part of the primary treatment and should not be assessed as new subsequent anticancer therapy., TSST defined as the time from the date of randomisation to the date of second subsequent anticancer therapy or death from any cause, whichever occurs first. Planned post-operative chemotherapy and planned maintenance therapy is considered as a part of the primary treatment and should not be assessed as new subsequent anticancer therapy., Change in biomarker (CA125)., Changes from baseline in patient reported outcome scores using QoL forms European Organization for Research and Treatment of Cancer (EORTC) QLQ-C30 and QLQ- OV28.

Source: https://euclinicaltrials.eu/ctis-public/view/2023-508497-28-00